EU clinical trial 2024-515635-30-00: A study to learn about how safe BAY 3389934 is, its suitable dose, and how it affects the participants with sepsis and coagulopathy
Protocol code: 22265
Sponsor: Bayer AG (Pharmaceutical company). Phase: Human Pharmacology (Phase I)- Other. Countries: France (ongoing, recruiting), Germany (ongoing, recruiting), Belgium (ongoing, recruitment ended), Netherlands (authorised, recruiting).
Therapeutic area(s): Diseases [C] - Cardiovascular Diseases [C14]
Gender: Female, Male. Age: 18-64 years, 65+ years. Enrolment: 36.
Start date (EU): 2026-03-24. Decision date: 2025-02-04. Results received: No. Last updated: 2026-07-22.
Decision dates by country: DE: 2025-02-04, BE: 2025-04-18, FR: 2025-02-05, NL: 2025-04-18

Condition(s): Sepsis, Coagulopathy

Source: https://euclinicaltrials.eu/ctis-public/view/2024-515635-30-00